EU clinical trial 2023-509178-44-00: Avian and seasonal influenza vaccine induced immune responses
Protocol code: Avian_inf_vacc_THL20
Sponsor: Finnish Institute For Health And Welfare (Laboratory/Research/Testing facility). Phase: Therapeutic use (Phase IV). Countries: Finland (ongoing, recruiting).
Therapeutic area(s): Diseases [C] - Respiratory Tract Diseases [C08]; Diseases [C] - Virus Diseases [C02]
Gender: Female, Male. Age: 18-64 years, 65+ years. Enrolment: 300.
Status: Ongoing, recruiting. Start date (EU): 2024-06-26. Decision date: 2024-04-19. Results received: No. Last updated: 2026-01-21.
Decision dates by country: FI: 2024-06-07

Condition(s): Avian influenza and seasonal influenza
Product: Fluad Tetra, suspension for injection in pre-filled syringe Influenza vaccine (surface antigen, inactivated, adjuvanted), Zoonotic Influenza Vaccine Seqirus suspension for injection in pre-filled syringe Zoonotic influenza vaccine (H5N8) (surface antigen, inactivated, adjuvanted), Vaxigrip injektioneste, suspensio, esitäytetty ruisku. Kolmivalenttinen influenssarokote (virusfragmentit, inaktivoitu)., Fluad suspension for injection in pre-filled syringe Influenza vaccine (surface antigen, inactivated, adjuvanted), Zoonotic Influenza Vaccine Seqirus suspension for injection in pre-filled syringe. Zoonotic influenza vaccine (H5N1) (surface antigen, inactivated, adjuvanted)., VaxigripTetra, injektioneste, suspensio, esitäytetty ruisku. Nelivalenttinen influenssarokote (virusfragmentit, inaktivoitu)

Primary endpoint: Primary outcome measure: Seroconversion proportion in all study subjects 3 weeks after the second dose given at least 21 days after the first dose, as assessed by the microneutralization test
Endpoint(s): Rate of seroconversion defined as the percentage of subjects with either a pre-vaccination MNT titer < 1:10 and a post vaccination MNT titer ≥ 1:80 or a pre-vaccination MNT titer ≥ 1:10 and a minimum four-fold rise in post-vaccination HI antibody titer., Geometric mean titers at pre- and post-vaccination, Detectable increase in T cell (CD4+ and CD8+) responses against H5N1 virus specific antigens in avian influenza virus vaccinated individuals

Source: https://euclinicaltrials.eu/ctis-public/view/2023-509178-44-00